EU clinical trial 2024-513151-33-00: Phase I-II, Multicenter, Randomized, Controlled, Proof of Concept Clinical Trial to determine feasibility, safety and efficacy of the use of Allogenic adipose-derived adult mesenchymal stem cells expanded on fibrin-hyaluronic biological matrix in the treatment of venous ulcer of the lower limbs.
Sponsor: Fundacion Progreso Y Salud (Patient organisation/association). Phase: Phase I and Phase II (Integrated)- Other. Countries: Spain (temporarily halted).
Therapeutic area(s): Diseases [C] - Cardiovascular Diseases [C14]
Gender: Female, Male. Age: 18-64 years, 65+ years. Enrolment: 20.
Status: Temporarily halted. Start date (EU): 2024-01-19. Decision date: 2024-04-22. Results received: No. Last updated: 2025-11-26.

Condition(s): Venous ulcer of the lower limbs
Product: Bioengineered Artificial Mesenchymal Sheet (BAMS)

Primary endpoint: Feasibility and Safety
Endpoint(s): 1.To determine the effect of the IMP on wound closure time compared to control group.2.To assess the effect of the IMP on the healing evolution of the lesion vs control group.3.To assess the effect of IMP on the concentration of GF closely related to wound healing.4.Evaluate the evolution of pain derived from the presence of UVs in the group treated with the IMP vs control group.5.To determine the perceived quality of life after treatment with the IMP vs control group.

Source: https://euclinicaltrials.eu/ctis-public/view/2024-513151-33-00